EU clinical trial 2024-520004-26-00: Randomized double blind phase 2 trial of baby exemestane versus baby tamoxifen in post-menopausal women at high risk for breast cancer. BabyTEARS (Baby Tamoxifen or Exemestane Assessment Randomized Study)
Protocol code: BabyTEARS
Sponsor: Ente Ospedaliero Ospedali Galliera Di Genova (Hospital/Clinic/Other health care facility). Phase: Therapeutic exploratory (Phase II). Countries: Italy (ongoing, recruiting), Portugal (authorised, recruiting).
Therapeutic area(s): Diseases [C] - Neoplasms [C04]
Gender: Female. Age: 18-64 years, 65+ years. Enrolment: 95.
Start date (EU): 2025-10-01. Decision date: 2025-07-15. Results received: No. Last updated: 2026-07-31.
Decision dates by country: IT: 2025-07-15, PT: 2026-03-03

Condition(s): Breast cancer
Product: EXEMESTANE, TAMOXIFEN

Primary endpoint: The primary endpoint is the difference between the mean changes of individual scores (overall MENQOL) between the two arms, where the change is the difference between baseline and 12 months.
Endpoint(s): The difference in sex hormones (free estradiol: estradiol/SHBG) and IGF system (IGF-I, IGFBP-3 and their ratio) after 12 months., The difference between arms in the overall MENQOL score after 6 months of treatment., Sex hormones (free estradiol, estradiol/SHBG), IGF system (IGF-I, IGFBP-3 and their ratio) at 6 months. The difference between arms in each of the four individual MENQOL domain scores (physical, vasomotor, sexual and psychosocial) at 6 and 12 months., The difference between arms of toxicity and safety profile according to CTCAE v.5 at 6 and 12 months., The difference between arms at 6 and 12 months in PMAS, Promise Medication Adherence Scale, a validated tool to measure pill adherence., The difference between arms on BPI Brief Pain Inventory at 6 and 12 months., The difference between arms in C-telopetide at 6 and 12 months., Patient uptake at screening/baseline phase will be measured with a questionnaire including factors related to breast cancer worry and presence of life style risk factors, and participant satisfaction for study explanation., Toxicity of babyexe in comparison with full dose historical controls treated in the adjuvant setting will also be evaluated.

Source: https://euclinicaltrials.eu/ctis-public/view/2024-520004-26-00